EU clinical trial 2024-512219-37-00: Early detection of side effects in patients with metastatic melanoma receiving immune checkpoint inhibitor therapy by investigation of the CD8+ immune infiltrate using [89Zr]Zr-Df-IAB22M2C-PET
Protocol code: CD8-PET
Sponsor: Universitaetsklinikum Tuebingen AöR (Hospital/Clinic/Other health care facility). Phase: Therapeutic exploratory (Phase II). Countries: Germany (ongoing, recruiting).
Therapeutic area(s): Diseases [C] - Skin and Connective Tissue Diseases [C17]
Gender: Female, Male. Age: 18-64 years, 65+ years. Enrolment: 35.
Status: Ongoing, recruiting. Start date (EU): 2022-09-06. Decision date: 2024-03-13. Results received: No. Last updated: 2024-03-13.

Condition(s): melanoma
Product: [89Zr]Zr-Df-IAB22M2C-UKT

Primary endpoint: Number of patients for whom [89Zr]Zr-Df-IAB22M2C PET-imaging was feasible.
Endpoint(s): Number of patients who are affected by 3/4 (CTCAE) ICT related side effects with detectable differences in [89Zr]Zr-Df-IAB22M2C PET-imaging before and after the first cycle of ICT., Absolute uptake of [89Zr]Zr-Df-IAB22M2C as assessed by PET imaging before the first cycle of ICT in the organs predisposed for immune related side effects and lymphatic tissue in the patients with autoimmune side effects grade 3/4 (CTCAE) induced by ICT compared to patients without grade 3/4 (CTCAE) autoimmune side effects of ICT., % uptake difference of [89Zr]Zr-Df-IAB22M2C before and after the first cycle of ICT in the organs predisposed for immune related side effects and the lymphatic tissue in the patients with autoimmune grade 3/4 (CTCAE) side effects induced by ICT compared to patients without autoimmune side effects of ICT., Number of patients with detectable differences in [89Zr]Zr-Df-IAB22M2C uptake before and after the first cycle of ICT in the tumors, metastasis or the lymphatic tissue, who are showing a clinical response to ICT., Absolute uptake of [89Zr]Zr-Df-IAB22M2C before the first cycle of ICT in the tumors, metastasis and lymphatic tissue in the patients who are showing a clinical response to ICT compared to non-responders., % uptake difference of [89Zr]Zr-Df-IAB22M2C uptake before and after the first cycle of ICT in the tumors and metastasis as well as in the lymphatic organs in patients who are showing a clinical response to ICT.

Source: https://euclinicaltrials.eu/ctis-public/view/2024-512219-37-00